EU clinical trial 2024-515616-47-00: A Randomized, Double-Blind, Controlled Phase 3 Study of Cabozantinib in Combination with Nivolumab and Ipilimumab versus Nivolumab and Ipilimumab in Subjects with Previously Untreated Advanced or Metastatic Renal Cell Carcinoma of Intermediate or Poor Risk
Protocol code: XL184-313
Sponsor: Exelixis Inc. (Pharmaceutical company). Phase: Therapeutic confirmatory (Phase III). Countries: Italy (ongoing, recruitment ended), Czechia (ended), Germany (ended), Poland (ongoing, recruitment ended), Spain (ongoing, recruitment ended), Belgium (ended), Netherlands (ended), Finland (ended), France (ended).
Therapeutic area(s): Diseases [C] - Neoplasms [C04]
Gender: Female, Male. Age: 18-64 years, 65+ years. Enrolment: 338.
Start date (EU): 2019-10-03. Decision date: 2024-10-14. Results received: No. Last updated: 2026-06-05.
Decision dates by country: BE: 2024-10-16, CZ: 2024-10-17, FI: 2024-10-15, DE: 2024-10-15, IT: 2024-10-21, ES: 2024-10-14, NL: 2024-10-27, PL: 2024-11-07, FR: 2024-12-23

Condition(s): Metastatic Renal Cell Carcinoma
Product: CABOMETYX 20 mg film-coated tablets, Placebo Tablets matching Cabozantinib (XL184) 20mg tablets., YERVOY 5 mg/ml concentrate for solution for infusion, OPDIVO 10 mg/mL concentrate for solution for infusion.

Primary endpoint: Duration of PFS (Progression-Free Survival), per Response Evaluation Criteria in Solid Tumors version 1.1 (RECIST 1.1), by Blinded Independent Radiology Committee (BIRC)
Endpoint(s): Duration of OS (overall survival)

Source: https://euclinicaltrials.eu/ctis-public/view/2024-515616-47-00